EU clinical trial 2023-509892-17-00: A Phase 2/3, Open-Label, Randomized, Controlled, Multicenter Study of KYV-101, an Autologous Fully Human Anti-CD19 Chimeric Antigen Receptor T-Cell (CD19 CAR T) Therapy, Versus Ongoing Standard-Of-Care Immunosuppressive Therapy in Patients with Generalized Myasthenia Gravis (KYSA-6)
Protocol code: KYV101-006
Sponsor: Kyverna Therapeutics Inc. (Pharmaceutical company). Phase: Phase II and Phase III (Integrated). Countries: Germany (ongoing, recruiting).
Therapeutic area(s): Diseases [C] - Immune System Diseases [C20]
Gender: Female, Male. Age: 18-64 years, 65+ years. Enrolment: 17.
Status: Ongoing, recruiting. Start date (EU): 2024-07-09. Decision date: 2024-05-13. Results received: No. Last updated: 2026-07-14.

Condition(s): Generalized myasthenia gravis
Product: Methotrexate 2.5 mg Tablets, CellCept 250 mg capsules, Privigen 100 mg/ml solution for infusion, Prograf 1 mg Hartkapseln, KYV-101, Methotrexate 2.5 mg Tablets, Methotrexate 2.5 mg Tablets, NEORAL® Soft Gelatin Capsules 100mg, NEORAL® Soft Gelatin Capsules 50mg, Zilbrysq 23 mg solution for injection in pre-filled syringe, Prednisolone 5mg Tablets, Ultomiris 300 mg/30 mL concentrate for solution for infusion, NEORAL® Soft Gelatin Capsules 100mg, NEORAL® Soft Gelatin Capsules 50mg, Methotrexate 2.5 mg Tablets, Zilbrysq 16.6 mg solution for injection in pre-filled syringe, Methotrexate 2.5 mg Tablets, NEORAL® Soft Gelatin Capsules 10mg, Soliris 300 mg concentrate for solution for infusion, NEORAL® Soft Gelatin Capsules 25mg, NEORAL® Soft Gelatin Capsules 25mg, Azathioprine Tablets 50mg Oprisine, NEORAL® Soft Gelatin Capsules 10mg, NEORAL® Soft Gelatin Capsules 10mg

Primary endpoint: 1. Phase 2: Incidence and severity of AEs and laboratory abnormalities., 2. Phase 2: MG-ADL change from baseline at 24 weeks., 3. Phase 3: MG-ADL change from baseline at 24 weeks for KYV-101 compared to SOC (co-primary), 4. Phase 3: QMG change from baseline at 24 weeks for KYV-101 compared to SOC (co-primary)
Endpoint(s): 1. Phase 3: MGC change from baseline at 24 weeks for KYV-101 compared to SOC., 2. Phase 3: Percent change from baseline in anti-AChR or anti-MuSK antibody levels at week 24 for KYV-101 compared to SOC., 3. Phase 3: Proportion of patients with a ≥3 point improvement from baseline in MG-ADL at 24 weeks for KYV-101 compared to SOC., 4. Phase 3: Proportion of patients with MSE at week 24 for KYV-101 compared to SOC., 5. Phase 3: MG-QoL15r change from baseline at 24 weeks for KYV-101 compared to SOC., 6. Phase 3: Incidence and severity of AEs and laboratory abnormalities.

Source: https://euclinicaltrials.eu/ctis-public/view/2023-509892-17-00